EU clinical trial 2024-514282-19-00: Evaluation of the efficacy of sphenopalatine block in headache in patients with non-traumatic subarachnoid hemorrhage (SAH) after training of neurosurgical intensive care nurses.
Protocol code: 38RC23.0226 SATURN
Sponsor: Centre Hospitalier Universitaire Grenoble Alpes (Hospital/Clinic/Other health care facility). Phase: Therapeutic exploratory (Phase II). Countries: France (ongoing, recruiting).
Therapeutic area(s): Analytical, Diagnostic and Therapeutic Techniques and Equipment [E] - Anesthesia and Analgesia [E03]
Gender: Female, Male. Age: 18-64 years, 65+ years. Enrolment: 70.
Status: Ongoing, recruiting. Start date (EU): 2025-05-30. Decision date: 2024-11-26. Results received: No. Last updated: 2026-07-10.

Condition(s): subarachnoid hemorrhage
Product: NEFOPAM PANPHARMA 20 mg/2 mL, solution injectable/pour perfusion, MORPHINE (CHLORHYDRATE) AGUETTANT 10 mg/mL, solution injectable, LIDOCAINE AGUETTANT 20 mg/mL SANS CONSERVATEUR, solution injectable, Paracetamol 10mg/ml solution for infusion, XYLOCAINE VISQUEUSE 2 %, gel oral, LIDOCAÏNE KABI 20 mg/mL, solution injectable

Primary endpoint: Total morphine consumption in mg for the first 72 hours after cerebral arteriography in the ICU.
Endpoint(s): 1. EN: (Simple Numerical Scale) 7-day average, 2. Morphine consumption in mg per day during hospitalization., 3. Complications of the sphenopalatine block technique: incidence of soft palate anesthesia (false routes to liquids at H+2), epistaxis, vasovagal reactions, transient hearing loss., 4. Number of BGSP failures, 5. Daily intake of non-steroidal anti-inflammatory drugs (NSAIDs) in milligrams during admission to the intensive care unit or up to 7 days, 6. EN at D28, consumption of stage 3 analgesics or neuropathic painkillers., 7. Overall pain management satisfaction questionnaire, 8. Satisfaction questionnaire for nurses

Source: https://euclinicaltrials.eu/ctis-public/view/2024-514282-19-00